EU clinical trial 2022-503148-41-00: Randomised, double-blind, placebo-controlled study to assess safety and efficacy of PRI-002 in patients with MCI or mild dementia due to Alzheimer’s disease (AD)
Protocol code: PRI-002-04
Sponsor: Prinnovation GmbH (Pharmaceutical company). Phase: Therapeutic exploratory (Phase II). Countries: France (not authorised), Netherlands (ended), Spain (ended), Italy (ended), Poland (ended), Germany (ended), Czechia (ended).
Therapeutic area(s): Diseases [C] - Nervous System Diseases [C10]
Gender: Female, Male. Age: 18-64 years, 65+ years. Enrolment: 339.
Status: Ended. Start date (EU): 2023-12-01. End date (EU): 2026-07-02. Decision date: 2023-10-27. Results received: No. Last updated: 2026-06-18.
Decision dates by country: FR: 2023-10-27, PL: 2023-10-30, IT: 2023-10-30, DE: 2023-10-30, CZ: 2023-10-30, NL: 2023-10-27, ES: 2023-10-27

Condition(s): Alzheimer's disease
Product: PRI-002, Placebo for PRI-002

Primary endpoint: Percentage of subjects with at least 1 drug-related AE or drug-related serious adverse event (SAE) between Baseline and Week 48, Change from Baseline to Week 48 in global outcome as measured by CDR-SB.
Endpoint(s): Percentage of subjects with AEs and SAEs from Baseline until End of Study (EoS), Percentage of subjects with ARIA-E and ARIA-H from Baseline until End of Treatment (EoT), Percentage of subjects who stopped treatment due to AEs or SAEs from Baseline until EoT, Change from baseline to Week 48, of: • Alzheimer's disease cooperative study - activities of daily living inventory (ADCS-ADL) • Alzheimer disease assessment scale - cognitive subscale, 13 tests (ADAS-Cog 13), Change from Baseline to EoT of: Cerebrospinal fluid (CSF) concentrations of AD‐related biomarkers including, but not limited to, ratio Aβ 1-42/1-40, p-tau, t-tau, Aβ oligomers, tau oligomers, Change from Baseline to EoT of: Plasma concentrations of AD-related biomarkers including, but not limited to, ratio Aβ 1-42/1-40, p-tau, t-tau, neurofilament light chain (NfL), glial fibrillary acidic protein (GFAP) and Aβ oligomers, PRI-002 plasma concentrations over time, Change from Baseline to EoT of: Mini mental state examination (MMSE) scores, Change from Baseline to EoT of: • CDR-SB • ADCS-ADL • ADAS-Cog 13, Change from Baseline to EoT of: Relationship between changes in CSF and plasma biomarkers and clinical changes (CDR‐SB, ADCS‐ADL, ADAS‐Cog 13, MMSE), Relationships between PRI‐002 plasma concentrations and clinical changes (CDR‐SB, ADCS‐ADL, ADAS‐Cog 13, MMSE) and safety endpoints (AEs and SAEs)

Source: https://euclinicaltrials.eu/ctis-public/view/2022-503148-41-00